EU clinical trial 2025-524102-15-00: Safety and tolerability of medicated chewing gum with sodium alginate, calcium carbonate and sodium bicarbonate.
Protocol code: BLCL-ACB-PIL01
Sponsor: Laboratorios Liconsa S.A. (Pharmaceutical company). Phase: Human Pharmacology (Phase I)- Other. Countries: Portugal (ended).
Therapeutic area(s): Not possible to specify
Gender: Female, Male. Age: 18-64 years. Enrolment: 16.
Status: Ended. Start date (EU): 2026-04-29. End date (EU): 2026-06-01. Decision date: 2026-02-02. Results received: No. Last updated: 2026-05-07.

Condition(s): No medical condition.

Source: https://euclinicaltrials.eu/ctis-public/view/2025-524102-15-00